EU clinical trial 2023-506931-13-00: Efficacy and safety of cagrilintide s.c. in combination with semaglutide s.c. (CagriSema s.c.) once-weekly in participants with overweight or obesity and type 2 diabetes
Protocol code: NN9838-4609
Sponsor: Novo Nordisk A/S (Pharmaceutical company). Phase: Therapeutic confirmatory (Phase III). Countries: Ireland (ended), Hungary (ended), Austria (ended), Poland (ended), Germany (ended).
Therapeutic area(s): Diseases [C] - Nutritional and Metabolic Diseases [C18]
Gender: Female, Male. Age: 18-64 years, 65+ years. Enrolment: 422.
Status: Ended. Start date (EU): 2023-01-30. End date (EU): 2025-01-28. End date: 2025-02-03. Decision date: 2024-07-01. Results received: Yes. Last updated: 2025-09-19.
Decision dates by country: IE: 2024-07-01, PL: 2024-07-05, HU: 2024-07-02, AT: 2024-08-05, DE: 2024-07-02

Condition(s): Overweight and obesity and type 2 diabetes
Product: cagrilintide semaglutide, cagrilintide semaglutide, cagrilintide semaglutide, cagrilintide semaglutide, Placebo + Placebo, cagrilintide semaglutide

Primary endpoint: Relative change in body weight, Achievement of ≥ 5% weight reduction
Endpoint(s): Achievement of ≥ 20% weight reduction, Relative change in body weight, Change in waist circumference, Change in Glycated Haemoglobin (HbA1c), Change in Systolic Blood Pressure (SBP), Change in Impact of Weight on Quality Of Life-Lite Clinical Trials Version (IWQOL-Lite-CT) Physical Function score, Change in SF-v2 Health Survey Acute (SF-36v2 Acute) Physical Functioning score, Number of Treatment Emergent Adverse Events (TEAEs), Number of Treatment Emergent Serious adverse events (TESAEs), Number of clinically significant hypoglycaemic episodes (level 2) (<3.0 mmol/L (54 mg/dL), confirmed by BG meter), Number of severe hypoglycaemic episodes (level 3): hypoglycaemia associated with severe cognitive impairment requiring external assistance for recovery, with no specific glucose threshold

Source: https://euclinicaltrials.eu/ctis-public/view/2023-506931-13-00